EU clinical trial 2024-516565-36-00: Therapeutic evaluation of low-dose IL-2-based immunomodulatory approach in patients with early AD
Protocol code: D20-P012
Sponsor: Groupe Hospitalier Universitaire Paris Psychiatrie Et Neuroscience (Hospital/Clinic/Other health care facility). Phase: Therapeutic exploratory (Phase II). Countries: France (ongoing, recruitment ended).
Therapeutic area(s): Diseases [C] - Nervous System Diseases [C10]
Gender: Female, Male. Age: 18-64 years, 65+ years. Enrolment: 45.
Status: Ongoing, recruitment ended. Start date (EU): 2024-11-14. Decision date: 2024-11-14. Results received: No. Last updated: 2025-06-13.

Condition(s): Alzheimer Disease
Product: PROLEUKIN 18 millions U.I., poudre pour solution injectable, CHLORURE DE SODIUM 0,9 % B. BRAUN, solution injectable en ampoule

Primary endpoint: 10/12/2026
Endpoint(s): 10/06/2027

Source: https://euclinicaltrials.eu/ctis-public/view/2024-516565-36-00